EU clinical trial 2023-507010-27-00: CUSHMAH - Benefit of steroidogenesis inhibitors in Mild Cushing syndrome (Mild Autonomous Cortisol Secretion): a randomized trial in patients with Primary Bilateral Macronodular Adrenocortical Hyperplasia
Protocol code: APHP211003
Sponsor: Assistance Publique Hopitaux De Paris (Hospital/Clinic/Other health care facility). Phase: Therapeutic confirmatory (Phase III). Countries: France (authorised, recruitment pending).
Therapeutic area(s): Diseases [C] - Nutritional and Metabolic Diseases [C18]; Diseases [C] - Hormonal diseases [C19]
Gender: Female, Male. Age: 18-64 years, 65+ years. Enrolment: 70.
Status: Authorised, recruitment pending. Decision date: 2026-03-05. Results received: No. Last updated: 2026-03-05.

Condition(s): Primary Bilateral Macronodular Adrenal Hyperplasia causing moderate Cushing Syndrome (Mild autonomous Cortisol secretion)
Product: METYRAPONE ESTEVE 250 mg, capsule molle, Placebo of metyrapon 250 mg

Primary endpoint: At 6 months of treatment number of patients achieving: 1) improvement of blood pressure control and/or 2) improvement of diabetes
Endpoint(s): Change of urinary cortisol, salivary cortisol during the circadian rhythm, steroid profile (mass spectrometry analysis) and morning ACTH plasma level at M0, M3 and M6, Evolution of Body Mass Index, insulin sensitivity as determined by HOMA, glycemia as determined by glucose continuous monitoring, total cholesterol, HDL, LDL, triglyceride at M0, M3 and M6, Mean change from baseline to M6 in day-time and night-time Systolic and Diastolic Blood Pressure irrespective of antihypertensive treatment adaptations, Mean change from baseline to M6 in HbA1c irrespective of antidiabetic treatment adaptations, Change in the score of the 3 following quality of life and depression questionnaires at M0, M3 and M6: Medical Outcomes Study 36-item short-form health survey (SF-36), the Beck depression inventory (BECK BDI-II) and the QolCushing, Comparaison of the hormonal and clinical response according to the ARMC5, PDE11A4 and NR3C1 genotypes., Collecting data on adverse events

Source: https://euclinicaltrials.eu/ctis-public/view/2023-507010-27-00